EU clinical trial 2023-504024-26-00: ICG-fluorescence imaging for intraoperative breast cancer margins evaluation: a dose-timing study
Protocol code: IJB-IFIBC-2022/01
Sponsor: Institut Jules Bordet (Hospital/Clinic/Other health care facility). Phase: Therapeutic exploratory (Phase II). Countries: Belgium (ongoing, recruiting).
Therapeutic area(s): Diseases [C] - Neoplasms [C04]
Gender: Female. Age: 18-64 years, 65+ years. Enrolment: 250.
Status: Ongoing, recruiting. Start date (EU): 2024-02-09. Decision date: 2023-12-15. Results received: No. Last updated: 2023-12-15.

Condition(s): Patients with primary invasive early breast cancer (T1-T2) that will undergo planned breast-conserving surgery
Product: INDOCYANINE GREEN

Primary endpoint: Accuracy of ICG-FI technique for the detection of positive (involved) surgical margins
Endpoint(s): Comparison of ICG-FI technique accuracy at different doses and timing, Characterization of the breast tumor fluorescence (tumor-to-background fluorescence ratio), Evaluation of fluorescence intensity of axillary lymph nodes

Source: https://euclinicaltrials.eu/ctis-public/view/2023-504024-26-00